EU clinical trial 2024-514687-33-00: Venetoclax and delayed rituximab with ibrutinib consolidation aiming at undetectable minimal residual disease (uMRD) in treatment-naïve patients with chronic lymphocytic leukemia (CLL)
Sponsor: Ospedale San Raffaele S.r.l. (Hospital/Clinic/Other health care facility). Phase: Therapeutic exploratory (Phase II). Countries: Italy (ongoing, recruiting).
Therapeutic area(s): Diseases [C] - Neoplasms [C04]
Gender: Female, Male. Age: 18-64 years. Enrolment: 55.
Status: Ongoing, recruiting. Start date (EU): 2021-12-21. Decision date: 2024-08-05. Results received: No. Last updated: 2024-08-05.

Condition(s): Previously Untreated Chronic Lymphophatic Leukaemia
Product: VENETOCLAX

Primary endpoint: uMRD (<10-4) evaluated by 6-color cytofluorymetry in BM as the best response at any time during treatment up to 3 months after supplementation of combination therapy (VR or VR followed by VI)

Source: https://euclinicaltrials.eu/ctis-public/view/2024-514687-33-00